EU clinical trial 2024-517631-43-00: Phase III, multicenter, open-label, randomized clinical trial to evaluate efficacy of Sodium Zirconium Cyclosilicate (Lokelma) compared to standard of care to manage hyperkalemia in patients with chronic kidney disease (CKD)
Protocol code: KEEP-ON
Sponsor: Instituto De Investigacion Sanitaria Fundacion Para La Investigacion Del Hospital Clinico De Valencia-INCLIVA (Hospital/Clinic/Other health care facility). Phase: Therapeutic confirmatory (Phase III). Countries: Spain (ongoing, recruiting).
Therapeutic area(s): Diseases [C] - Pathological Conditions, Signs and Symptoms [C23]
Gender: Female, Male. Age: 18-64 years, 65+ years. Enrolment: 78.
Status: Ongoing, recruiting. Start date (EU): 2022-12-12. Decision date: 2024-09-16. Results received: No. Last updated: 2024-09-16.

Condition(s): Hyperkalemia in patients with chronic kidney disease
Product: Lokelma 5 g powder for oral suspension, Lokelma 10 g powder for oral suspension

Primary endpoint: Percentage of patients achieving serum potassium < 5.5mEq/L at three or all timepoints (7, 30, 60 or 90 days) after follow up (90 days) in both groups.

Source: https://euclinicaltrials.eu/ctis-public/view/2024-517631-43-00